EU clinical trial 2025-521526-15-00: PHASE IV, PROSPECTIVE, OPEN-LABEL, SINGLE ARM STUDY ON THE PAIN-RELIEF EFFECT OF BENZYDAMINE HYDROCHLORIDE LOZENGES 3 MG MINT TASTE (TANTUM VERDE) IN NON STREPTOCOCCAL PHARYNGOTONSILLITIS IN PEDIATRIC AGE (6-11 YEARS OLD).
Protocol code: 030(Z)MD24076
Sponsor: Angelini Pharma Italia Aziende Chimiche Riunite Angelini Francesc O A.C.R.A.F. S.p.A. Enunciabile Anche Angelini Pharma Italia S.p.A. Angelini Pharma S.p.A. A.C.R.A.F. S.p.A. Acraf S.p.A. Angelini S.p.A. Aziende Chimiche Riunite Angelini Francesco A.C.R.A.F. S.p.A. (Pharmaceutical company). Phase: Therapeutic use (Phase IV). Countries: Italy (authorised, recruitment pending).
Therapeutic area(s): Diseases [C] - Respiratory Tract Diseases [C08]
Gender: Female, Male. Age: 0-17 years. Enrolment: 120.
Status: Authorised, recruitment pending. Decision date: 2026-04-30. Results received: No. Last updated: 2026-04-30.

Condition(s): NON STREPTOCOCCAL PHARYNGOTONSILLITIS
Product: Tantum Verde P 3 mg pastiglie gusto menta

Primary endpoint: Repeated-measures association during the first 60 minutes after first lozenge placement between change from baseline in the percentage of pharyngotonsillar surface area above the pre-specified temperature threshold, assessed centrally on duplicate infrared images., Repeated-measures association during the first 60 minutes after first lozenge placement between change from baseline in WBFPRS assessed at 5, 10, 15, 20, 25, 30 and 60 minutes.
Endpoint(s): Time from first lozenge placement to first clinically meaningful pain reduction (≥2-point decrease in WBFPRS)., Time from first lozenge placement to first predefined thermographic improvement (defined as a relative reduction from baseline of at least 15% in the percentage of pharyngotonsillar surface area above the prespecified temperature threshold)., Proportion of participants with clinically meaningful pain reduction at 5, 10, 15, 20, 25, 30, 60 minutes and at 24, 48 and 72 hours., Mean and median change from baseline in WBFPRS at each scheduled time-point., Time to complete pain disappearance (WBFPRS = 0)., Number of lozenges taken before complete pain disappearance., Descriptive association between change from baseline in the percentage of pharyngotonsillar surface area above the pre-specified temperature threshold and change from baseline in WBFPRS over 24, 48 and 72 hours., Supportive analyses referenced to the time of complete lozenge dissolution., Need for paracetamol and/or antibiotics during the study., Safety outcomes including adverse events, vital signs, oral temperature, and physical examination findings., Number and percentage of patients who discontinued the investigational medicinal product, with the reason for discontinuation.

Source: https://euclinicaltrials.eu/ctis-public/view/2025-521526-15-00